EU clinical trial 2023-504205-36-00: Routine versus selective protamine administration to reduce bleeding complications after transcatheter aortic valve implantation
Protocol code: 2023-504205-36-00
Sponsor: St Antonius Hospital (Hospital/Clinic/Other health care facility). Phase: Phase III and phase IV (Integrated). Countries: Netherlands (ended), Belgium (ended).
Therapeutic area(s): Diseases [C] - Cardiovascular Diseases [C14]; Analytical, Diagnostic and Therapeutic Techniques and Equipment [E] - Therapeutics [E02]
Gender: Female, Male. Age: 18-64 years, 65+ years. Enrolment: 800.
Status: Ended. Start date (EU): 2023-11-01. End date (EU): 2026-01-02. Decision date: 2023-06-13. Results received: No. Last updated: 2025-11-20.
Decision dates by country: BE: 2023-10-10, NL: 2023-06-13

Condition(s): Aortic stenosis
Product: Protamine sulfaat LEO Pharma 1400 anti-heparine IE/ml oplossing voor injectie en infusie, NaCl 0,9 % B. Braun, oplossing voor infusie

Primary endpoint: The composite of cardiovascular mortality or clinically relevant bleeding (VARC-3 type 1-4) within 30 days after TAVI procedure.
Endpoint(s): All bleeding (VARC-3 type 1-4), Major, life-threatening or fatal bleeding (VARC-3 type 2-4), Major vascular complications (VARC-3), Cardiovascular mortality (VARC-3), All-cause mortality

Source: https://euclinicaltrials.eu/ctis-public/view/2023-504205-36-00